EU clinical trial 2023-509742-35-00: A Phase 2a, Multi-Center, Open-Label Study to Evaluate the Safety, Efficacy, and Pharmacokinetics of PRA023 in Subjects with Moderately to Severely Active Crohn’s Disease
Protocol code: PR200-103
Sponsor: Prometheus Biosciences Inc. (Pharmaceutical company). Phase: Therapeutic exploratory (Phase II). Countries: France (ended), Poland (ended), Czechia (ended).
Therapeutic area(s): Diseases [C] - Digestive System Diseases [C06]
Gender: Female, Male. Age: 18-64 years, 65+ years. Enrolment: 6.
Status: Ended. Start date (EU): 2021-11-17. End date (EU): 2025-06-24. End date: 2025-06-25. Decision date: 2024-08-30. Results received: Yes. Last updated: 2025-01-27.
Decision dates by country: CZ: 2024-08-30, FR: 2024-09-03, PL: 2024-08-30

Condition(s): Crohn's disease
Product: tulisokibart

Primary endpoint: • Safety and tolerability: the proportion of subjects reporting adverse events (AEs), serious adverse events (SAEs), AEs leading to discontinuation, and markedly abnormal laboratory values, • The proportion of subjects with endoscopic improvement, as defined by decrease in SES-CD ≥ 50% from Baseline at Week 12
Endpoint(s): • The proportion of subjects in clinical remission (CDAI < 150) at Week 12, • The proportion of subjects with endoscopic and clinical improvement, as defined by decrease in SES-CD ≥ 50% AND reduction in CDAI ≥ 100 points from Baseline at Week 12, • The proportion of subjects with both biomarker and clinical improvement (decrease in hsCRP OR fecal calprotectin ≥ 50% from Baseline, among subjects with at least one elevated biomarker at Baseline, AND reduction in CDAI ≥ 100 points from Baseline) at Week 12, • The proportion of subjects with normalization of hsCRP (as defined by hsCRP < ULN), among subjects with elevated concentrations at Baseline, at Week 12, • The proportion of subjects with normalization of fecal calprotectin (as defined by fecal calprotectin < ULN), among subjects with elevated concentrations at Baseline, at Week 12, • The proportion of subjects in clinical response, as defined by reduction in CDAI ≥ 100 points from Baseline at Week 12, • The proportion of subjects with PRO-2 remission (defined as average daily abdominal pain score ≤ 1 point and average daily stool frequency ≤ 3 points with abdominal pain and stool frequency no worse than Baseline) at Week 12, • Change in SES-CD score at Week 12 from Baseline, • Descriptive summaries of PK and immunogenicity of PRA023, • Proportion of subjects developing anti-drug antibody (ADA) and neutralizing antibody (Nab)

Source: https://euclinicaltrials.eu/ctis-public/view/2023-509742-35-00